EU clinical trial 2024-516743-34-00: A Study of Mezagitamab in Adults With Primary Immunoglobulin A Nephropathy Receiving Stable Background Therapy
Protocol code: TAK-079-1006
Sponsor: Takeda Development Center Americas Inc. (Pharmaceutical company). Phase: Human Pharmacology (Phase I)- Other. Countries: Spain (ended), Hungary (ended).
Therapeutic area(s): Diseases [C] - Immune System Diseases [C20]
Gender: Female, Male. Age: 18-64 years, 65+ years. Enrolment: 3.
Status: Ended. Start date (EU): 2022-07-25. End date (EU): 2025-03-25. End date: 2025-12-15. Decision date: 2024-10-14. Results received: No. Last updated: 2025-05-21.
Decision dates by country: ES: 2024-10-14, HU: 2024-10-15

Condition(s): IgAN is Primary Immunoglobulin A Nephropathy (IgAN) (also known as Berger's disease)

Source: https://euclinicaltrials.eu/ctis-public/view/2024-516743-34-00